EU clinical trial 2023-509353-31-00: A Phase 1b, Multicenter, Open-label Study of Acalabrutinib in Combination with Bendamustine and Rituximab (BR) or Venetoclax and Rituximab (VR) in Subjects with Mantle Cell Lymphoma
Protocol code: ACE-LY-106
Sponsor: Acerta Pharma B.V. (Pharmaceutical company). Phase: Human Pharmacology (Phase I)- Bioequivalence Study. Countries: Poland (ongoing, recruitment ended).
Therapeutic area(s): Diseases [C] - Neoplasms [C04]
Gender: Female, Male. Age: 18-64 years, 65+ years. Enrolment: 6.
Status: Ongoing, recruitment ended. Start date (EU): 2016-09-05. Decision date: 2024-07-29. Results received: No. Last updated: 2026-07-29.

Condition(s): Mantle Cell Lymphoma

Source: https://euclinicaltrials.eu/ctis-public/view/2023-509353-31-00